EU clinical trial 2025-521661-27-00: A Phase 2b/3 Adaptive, Randomized, Active controlled Study Evaluating the Efficacy, Safety, and Tolerability of Povetacicept Versus Calcineurin Inhibitor in the Treatment of Primary Membranous Nephropathy
Protocol code: VX24-AIS-D10
Sponsor: Vertex Pharmaceuticals Inc. (Pharmaceutical company). Phase: Phase II and Phase III (Integrated). Countries: Hungary (ongoing, recruiting), Ireland (ongoing, recruiting), Czechia (ongoing, recruiting), Italy (ongoing, recruiting), Spain (ongoing, recruiting), Germany (ongoing, recruiting), Netherlands (authorised, recruiting).
Therapeutic area(s): Diseases [C] - Immune System Diseases [C20]
Gender: Female, Male. Age: 18-64 years, 65+ years. Enrolment: 30.
Start date (EU): 2025-12-19. Decision date: 2025-12-12. Results received: No. Last updated: 2026-06-03.
Decision dates by country: CZ: 2025-12-12, NL: 2025-12-15, IE: 2025-12-16, DE: 2025-12-12, HU: 2025-12-16, IT: 2025-12-15, ES: 2025-12-16

Condition(s): Primary Membranous Nephropathy
Product: TACROLIMUS, ALPN-303 solution for injection, ALPN-303 solution for injection in pre-filled syringe, TACROLIMUS, Test IMP without active substance, TACROLIMUS, ALPN-303 Solution for Injection in Pre-filled Pen

Primary endpoint: Proportion of Participants with Complete Clinical Remission Definition 1 (CR1) CR1 [Time Frame: At Week 72]
Endpoint(s): Proportion of Participants with Complete Clinical Remission Definition 2 (CR2). [Time Frame: At Week 72], Proportion of Participants with Overall Clinical Remission (OR). [Time Frame: At Week 72], Safety and tolerability as determined by AEs, clinical laboratory values, standard 12-lead ECGs, and vital signs

Source: https://euclinicaltrials.eu/ctis-public/view/2025-521661-27-00